EU clinical trial 2023-506805-20-01: A Continuation Study of Latozinemab in Participants with Neurodegenerative Disease
Sponsor: Alector LLC (Pharmaceutical company). Phase: Therapeutic confirmatory (Phase III). Countries: Germany (ended), Portugal (ended), Italy (ended), Netherlands (ended), Belgium (ended), France (ended), Sweden (ended).
Therapeutic area(s): Diseases [C] - Nervous System Diseases [C10]
Gender: Female, Male. Age: 18-64 years, 65+ years. Enrolment: 32.
Status: Ended. Start date (EU): 2024-09-25. End date (EU): 2026-01-05. End date: 2026-01-07. Decision date: 2024-08-20. Results received: Yes. Last updated: 2025-10-14.
Decision dates by country: NL: 2024-08-20, PT: 2024-08-20, DE: 2024-08-22, IT: 2024-08-21, BE: 2025-10-14, FR: 2025-10-02, SE: 2025-10-08

Condition(s): Neurodegenerative Diseases
Product: latozinemab

Primary endpoint: Number of participants receiving latozinemab, Duration of treatment
Endpoint(s): Number, percentages, nature, and severity of adverse events (AEs) and serious adverse events (SAEs), Number and percentage of cases of the development of ADAs to latozinemab, Actual values of the CGI-S every 3 months, Actual values of the CGI-I every 3 months

Source: https://euclinicaltrials.eu/ctis-public/view/2023-506805-20-01